EU clinical trial 2023-507851-31-00: A Phase 3, Randomized, Double-Blind, Placebo-Controlled Study to Evaluate the Efficacy and Safety of Ravulizumab in Adult Participants with Immunoglobulin A Nephropathy (IgAN)
Protocol code: ALXN1210-IgAN-320
Sponsor: Alexion Pharmaceuticals Inc. (Pharmaceutical company). Phase: Therapeutic confirmatory (Phase III). Countries: Netherlands (ongoing, recruitment ended), Belgium (ongoing, recruitment ended), Hungary (ended), Spain (ongoing, recruitment ended), Austria (ongoing, recruitment ended), Poland (ongoing, recruitment ended), France (ongoing, recruitment ended), Germany (ongoing, recruitment ended), Italy (ongoing, recruitment ended), Czechia (ongoing, recruitment ended), Slovakia (ongoing, recruitment ended), Greece (ongoing, recruitment ended).
Therapeutic area(s): Diseases [C] - Immune System Diseases [C20]
Gender: Female, Male. Age: 18-64 years, 65+ years. Enrolment: 149.
Start date (EU): 2024-09-23. Decision date: 2024-07-02. Results received: No. Last updated: 2026-07-28.
Decision dates by country: HU: 2024-09-25, SK: 2024-09-20, FR: 2024-09-24, PL: 2024-07-05, CZ: 2024-09-20, GR: 2024-09-23, DE: 2024-09-20, IT: 2024-07-04, AT: 2024-07-08, BE: 2024-07-02, NL: 2024-07-08, ES: 2024-07-03

Condition(s): Immunoglobulin A Nephropathy (IgAN)
Product: Anti C5 Complement mAb Placebo, Ultomiris 1,100 mg/11 mL concentrate for solution for infusion

Primary endpoint: Interim Analysis: Change from baseline in proteinuria based on 24-hour UPCR at Week 34 Final Analysis: Change from Baseline in eGFR at Week 106
Endpoint(s): Interim Analysis: Change from Baseline in proteinuria based on 24-hour UPCR at Weeks 10 and 26 Final Analysis: Change from Baseline in proteinuria based on 24-hour UPCR at Week 10, 26, 34, 50 and 106, Interim Analysis: Change from Baseline in eGFR at Week 34 Final Analysis: Change from Baseline in eGFR at Weeks 34 and 50, Interim Analysis: Reduction in 24-hour UPCR ≥ 50% from Baseline over time Final Analysis: Reduction in 24-hour UPCR ≥ 50% from Baseline at Week 34 and over time, Interim Analysis: Partial remission over time final analysis: Partial remission over time, Interim Analysis: Change from Baseline in albuminuria over time final analysis: Change from Baseline in albuminuria over time, Interim Analysis: Annualized eGFR slope over 50 weeks Final analysis: Time to sustained ≥ 30% eGFR decline up to Week 106, Final analysis: Time to individual components of composite kidney event endpoint up to Week 106, interim analysis: Change from Baseline in FACIT-Fatigue at Week 34. final analysis: Change from Baseline in FACIT-Fatigue at Weeks 34, 50, and 106, interim and final analysis: Incidence of TEAEs, TESAEs, and AESI over time, interim and final analysis: ADA incidence, response categories, and titers; as well as NAb incidence for the duration for the study, interim and final analysis: • Serum ravulizumab concentrations over time • Serum total C5 and free C5 concentrations over time, Final Analysis: Time to first occurrence of composite kidney event endpoint up to Week 106, defined as reaching at least 1 of the following: −Sustained ≥ 30% decline in eGFR relative to Baselinea, or −Sustained eGFR < 15 mL/min/1.73 m2, or −Maintenance dialysis, or −Receipt of kidney transplant, or −Death from kidney failure, Final Analysis: Time to individual components of composite kidney event endpoint up to Week 106, Final analysis: Use of alternative IgAN therapy over time, final analysis: Change from Baseline in proteinuria based on 24-hour UPCR at Week 34 in participants with baseline UPCR ≥ 1.5 g/g, final analysis: Change from Baseline in proteinuria based on 24-hour UPCR at Week 34 in participants with baseline UPCR ≥ 1.5 g/g and presence of hematuria at baseline, final analyses: Change from Baseline in eGFR at Week 106 in Participants with Baseline UPCR ≥ 1.5 g/g

Source: https://euclinicaltrials.eu/ctis-public/view/2023-507851-31-00